EU clinical trial 2024-511245-18-00: Relative bioavailability of two different formulations of nerandomilast and investigation of the food effect on new formulation following oral administration in healthy adult male and female subjects (an open-label, randomised, single-dose, three-way crossover trial)
Protocol code: 1305-0029
Sponsor: Boehringer Ingelheim International GmbH (Pharmaceutical company). Phase: Human Pharmacology (Phase I)- Other. Countries: Germany (ended).
Therapeutic area(s): Not possible to specify
Gender: Female, Male. Age: 18-64 years. Enrolment: 15.
Status: Ended. Start date (EU): 2024-10-11. End date (EU): 2024-11-30. Decision date: 2024-08-08. Results received: Yes. Last updated: 2024-08-08.

Condition(s): Healthy volunteer trial
Product: BI 1015550, NERANDOMILAST

Primary endpoint: AUC0-tz (area under the concentration-time curve of the analyte in plasma over the time interval from 0 to the last quantifiable data point), Cmax (maximum measured concentration of the analyte in plasma)
Endpoint(s): AUC0-∞ (area under the concentration-time curve of the analyte in plasma over the time interval from 0 extrapolated to infinity)

Source: https://euclinicaltrials.eu/ctis-public/view/2024-511245-18-00